EU clinical trial 2023-505797-15-00: A Phase 3, Multi-Center, Randomized, Double-Blind Trial to Evaluate the Efficacy and Safety of Aficamten Compared to Placebo in Adults with Symptomatic Non-Obstructive Hypertrophic Cardiomyopathy
Protocol code: CY 6033
Sponsor: Cytokinetics Inc. (Pharmaceutical company). Phase: Therapeutic confirmatory (Phase III). Countries: Poland (ended), Spain (ended), Italy (ended), Hungary (ended), France (ended), Germany (ended), Netherlands (ended), Denmark (ended), Portugal (ended), Greece (ended), Iceland (ended).
Therapeutic area(s): Diseases [C] - Congenital, Hereditary, and Neonatal Diseases and Abnormalities [C16]
Gender: Female, Male. Age: 18-64 years, 65+ years. Enrolment: 175.
Status: Ended. Start date (EU): 2024-09-13. End date (EU): 2026-02-27. Decision date: 2024-03-04. Results received: No. Last updated: 2026-03-17.
Decision dates by country: PL: 2024-03-07, FR: 2024-03-08, GR: 2024-11-13, IT: 2024-03-11, IS: 2024-11-18, NL: 2024-03-11, ES: 2024-03-04, PT: 2024-03-06, HU: 2024-03-11, DE: 2024-03-07, DK: 2024-03-04

Condition(s): SYMPTOMATIC NON-OBSTRUCTIVE HYPERTROPHIC CARDIOMYOPATHY
Product: Tablet placebo for aficamten 5mg tablet, Aficamten

Primary endpoint: Dual primary endpoints of: • Change in KCCQ-CSS from baseline to Week 36 • Change in pVO2 from baseline to Week 36
Endpoint(s): Proportion of participants with ≥ 1 class improvement in NYHA Functional Class from baseline to Week 36, Change in the composite of two Z-scores of CPET parameters from baseline to Week 36: – pVO2 (maximal exercise capacity) – VE/VCO2 slope (sub-maximal exercise capacity), Change in NT-proBNP from baseline to Week 36, Change in LAVI from baseline to Week 36 in participants without atrial fibrillation or flutter at baseline on ECG., Time to first event of cardiovascular death, heart transplantation or left ventricular assist device, aborted sudden cardiac death, non-fatal stroke, heart failure hospitalization, or cardiac arrhythmia (atrial fibrillation or ventricular tachyarrhythmia) requiring treatment or hospitalization

Source: https://euclinicaltrials.eu/ctis-public/view/2023-505797-15-00